EU clinical trial 2024-519270-40-00: An Efficacy and Safety, Phase III, Multi-center, Double-Blind, Randomized Controlled Study Comparing 2 Active Doses of CYB003 and Placebo in Eligible Participants with Major Depressive Disorder (EMBRACE)
Protocol code: CYB003-003
Sponsor: Cybin IRL Limited (Pharmaceutical company). Phase: Therapeutic confirmatory (Phase III). Countries: Poland (ongoing, recruiting), Ireland (ongoing, recruiting), Greece (ongoing, recruiting), Czechia (authorised, recruitment pending), Germany (authorised, recruitment pending).
Therapeutic area(s): Psychiatry and Psychology [F] - Mental Disorders [F03]
Gender: Female, Male. Age: 18-64 years, 65+ years. Enrolment: 141.
Start date (EU): 2025-10-30. Decision date: 2025-08-05. Results received: No. Last updated: 2026-01-23.
Decision dates by country: IE: 2025-08-05, GR: 2025-08-11, CZ: 2026-01-23, DE: 2025-11-20, PL: 2025-08-11

Condition(s): Major Depressive Disorder
Product: CYB003, Placebo, CYB003

Primary endpoint: Change from Baseline (Day -1) to Day 42 in MADRS total score.
Endpoint(s): Change from Baseline (Day -1) to Day 84 in MADRS total score., Proportion of participants with response defined as a ≥50% decrease in MADRS total score from Baseline (Day -1) to Day 84. Response will also be assessed after each dosing session (Day 2 and Day 23) and through Day 84., Proportion of participants in remission defined as MADRS total score ≤10 at Day 84. Remission will also be assessed after each dosing session (Day 2 and Day 23) and through Day 84., Proportion of responders with a sustained response (sustained defined as those meeting response criteria on or before Day 42 and sustained through Day 84 with one score greater than that for the response criterion permitted)., Proportion of participants with a sustained remission (sustained defined as those meeting remission criteria on or before Day 42 and sustained through Day 84 with one score greater than that for the remission criterion permitted)., Change from Baseline to each timepoint assessed in BDI-II., Change from Baseline to each timepoint assessed in CGI-S score., CGI-I score at each timepoint to assess change since Baseline (Day -1)., Change from Baseline to each timepoint assessed in GAD-7 total score., Change from Baseline to each timepoint assessed in Q-LES-Q-SF total score.

Source: https://euclinicaltrials.eu/ctis-public/view/2024-519270-40-00